EU clinical trial 2024-515956-19-00: TociCCAre - Randomized, double-blind, multicenter trial of tocilizumab versus placebo in chronic polyarticular inflammatory of calcium pyrophosphate deposition disease refractory to standard treatments
Protocol code: APHP220790
Sponsor: Assistance Publique Hopitaux De Paris (Hospital/Clinic/Other health care facility). Phase: Therapeutic confirmatory (Phase III). Countries: France (authorised, recruitment pending).
Therapeutic area(s): Diseases [C] - Musculoskeletal Diseases [C05]
Gender: Female, Male. Age: 18-64 years, 65+ years. Enrolment: 80.
Status: Authorised, recruitment pending. Decision date: 2025-08-06. Results received: No. Last updated: 2026-02-11.

Condition(s): Chondrocalcinosis
Product: RoActemra 20 mg/mL concentrate for solution for infusion, Tofidence 20 mg/mL concentrate for solution for infusion, Avtozma 20 mg/mL concentrate for solution for infusion., SODIUM CHLORIDE, Tyenne 20 mg/ml concentrate for solution for infusion

Primary endpoint: Variation in overall pain VAS between initiation and M4, i.e. one month after the 3rd infusion
Endpoint(s): DAS44 (If the erythrocyte sedimentation rate (ESR) is not available, the DAS28-CRP will be used), number of swollen, painful joints, overall disease activity VAS, fatigue VAS, Overall effect on pain: area under the curve (AUC) of global pain VAS from assessments at inclusion, before each infusion at months M1, M2, M3 and at M4 and M6 (end of study), Proportion of patients responding from M2 to M6 (defined as an improvement ≥ 50% of the initial pain VAS), Proportion of complete response, defined as an improvement ≥ 80% of the initial pain VAS, from M2 to M6, Number of inflammatory flare-ups/month, Relapse rate at M6, Time to onset of relapse, Biological parameters of inflammation: SV, CRP, IL-6, Improvement in quality of life: SF-36, HAQ, EQ-5D-3L questionnaires, Consumption of care over 6 months: number of hospitalisations related to CPAP-dependent disease, duration of hospitalisations, duration of time off work, consumption of analgesics, Incidence of infusion reactions, Incidence of neutropenia, thrombocytopenia and hepatic cytolysis, Mean value of neutropenia, thrombocytopenia and transaminases, Incidence of severe infections, Incidence of any side effects attributable to treatment, Incidence of changes in lipid profile, Mean value of lipid profile, Demographic, disease, biological characteristics and comorbidities to identify factors linked to a response to tocilizumab

Source: https://euclinicaltrials.eu/ctis-public/view/2024-515956-19-00